EU clinical trial 2023-508465-32-00: A Randomized, Double-Blind, Placebo-Controlled Study to Evaluate the Efficacy and Safety of TAK-861 for the Treatment of Narcolepsy with Cataplexy (Narcolepsy Type 1)
Protocol code: TAK-861-3001
Sponsor: Takeda Development Center Americas Inc. (Pharmaceutical company). Phase: Therapeutic confirmatory (Phase III). Countries: Norway (ended), Spain (ended), Germany (ended), Netherlands (ended), France (ended), Italy (ended).
Therapeutic area(s): Diseases [C] - Nervous System Diseases [C10]
Gender: Female, Male. Age: 18-64 years, 65+ years. Enrolment: 85.
Status: Ended. Start date (EU): 2024-09-03. End date (EU): 2025-06-03. End date: 2025-06-04. Decision date: 2024-08-12. Results received: Yes. Last updated: 2025-04-02.
Decision dates by country: ES: 2024-08-13, NO: 2024-08-13, NL: 2024-08-13, FR: 2024-08-13, IT: 2024-08-14, DE: 2024-08-12

Condition(s): Narcolepsy with Cataplexy (Narcolepsy Type 1)
Product: TAK-861, TAK-861 placebo (same excipients as TAK-861), TAK-861

Primary endpoint: Change from baseline to Week 12 in ESS total score
Endpoint(s): Change from baseline to Week 12 in mean sleep latency from the 4 MWT wake trials., WCR at Week 12, Change from baseline to Week 12 in mean number of lapses on the PVT, PGI-C score at Week 12., Change from baseline to Week 12 in NSS-CT total score, Change from baseline to Week 12 in FINI domain scores for: Tiredness, Cognitive Functioning, Cataplexy, Social Activities, Everyday Activities, and Everyday Responsibilities., Change from baseline to Week 12 in SF-36 mental and physical component summary scores, Occurrence of at least 1 TEAE during the study including the follow-up period, as applicable

Source: https://euclinicaltrials.eu/ctis-public/view/2023-508465-32-00